EU clinical trial 2025-522656-68-00: Influence of patient’s morphological characteristics on pharmacokinetic and toxicity of trastuzumab-deruxtecan administered for metastatic breast cancers (TDXdose)
Protocol code: 25 SEIN 06
Sponsor: Oncopole Claudius Regaud (Hospital/Clinic/Other health care facility). Phase: Therapeutic use (Phase IV). Countries: France (ongoing, recruiting).
Therapeutic area(s): Diseases [C] - Neoplasms [C04]
Gender: Female, Male. Age: 18-64 years, 65+ years. Enrolment: 210.
Status: Ongoing, recruiting. Start date (EU): 2025-10-15. Decision date: 2025-10-08. Results received: No. Last updated: 2026-03-18.

Condition(s): Metastatic breast cancers
Product: Enhertu 100 mg powder for concentrate for solution for infusion

Primary endpoint: Plasma exposure of free-DXd (payload) will be measured by the cumulative AUC (Area under the concentration vs. time curve) over the first 3 cycles or until an event (interruption or dose concession for toxicity) divided by the number of corresponding cycles. These AUCs will be determined by Bayesian estimation (Posthoc values) using a non-linear mixed-effects approach. Differences between the two groups will be assessed using Student’s test (or Mann Whitney if applicable).
Endpoint(s): • Safety: Safety will be assessed through recording of adverse events using NCI-CTCAE toxicity classification v5.0. AEs will be summarized by descriptive statistics and differences between groups will be assessed using Chi-squared or Fisher’s exact test., • Efficacy: The Kaplan-Meier approach will be used to estimate PFS rates for each group. To consider immortal time bias, the association between plasma exposure (or plasma concentration) and PFS will be assessed using a Cox proportional hazards model with time-dependent variable. Cox model will be adjusted on clinico-pathological variables of interest. A complementary analysis will be conducted using Landmark approach at different time points., • Association between Progression Free Survival and body composition will be assessed using a similar approach to the one used for association with plasma exposure., • Association between plasma exposure and safety will be assessed using logistic regression models. The ORs and corresponding confidence intervals (CIs) will be reported.

Source: https://euclinicaltrials.eu/ctis-public/view/2025-522656-68-00